EU clinical trial 2023-510439-13-00: A phase III, randomized, double blind, multiple doses, placebo-controlled parallel-group, adaptive study to evaluate the efficacy of atropine to treat the progression of myopia in children and adolescents from 3 to less than 18 years of age (MODERATO Study)
Protocol code: OCUS-Mode-CT-V1
Sponsor: Ocus Innovation Ireland Limited (Pharmaceutical company). Phase: Therapeutic confirmatory (Phase III). Countries: Poland (ongoing, recruiting), Italy (ongoing, recruiting), Spain (ongoing, recruiting).
Therapeutic area(s): Diseases [C] - Eye Diseases [C11]
Gender: Female, Male. Age: 0-17 years. Enrolment: 137.
Status: Ongoing, recruiting. Start date (EU): 2025-09-25. Decision date: 2025-01-10. Results received: No. Last updated: 2026-05-19.
Decision dates by country: IT: 2025-01-13, PL: 2025-01-11, ES: 2025-01-10

Condition(s): Myopia
Product: Atropine Eye Drops, Solution (0.05% w/v), Atropine Eye Drops, Solution (0.025% w/v), The placebo consists of the same composition as the atropine eye drops except for the active substance.

Primary endpoint: Mean annual rate of progression of myopia (D/year) based on spherical equivalent (SE) measured by cycloplegic autorefraction through 24 months.
Endpoint(s): Number and percentage of early escape patients at 6 months., Mean change in axial length and glasses prescription at 3, 6, 12, 18 and 24 months., Safety at 3, 6, 12, 18 and 24 months, measuring: % children requiring photochromic and/or varifocal lenses counts and percentage of patients reporting any AEs change in photosensitivity index best corrected distance and near visual acuity pupil size and accommodation amplitude, Vision-related quality of life., Acceptability of the formulation: it will be assessed with a 3-item questionnaire, scored on a six-point scale., Overall between-group difference from baseline in the proportion of subjects who show < -0.50 D myopia progression (Spherical Equivalent Refraction, SER) at 24 months: Chi-square test, or Fisher's exact test, will be used to test for differences among three treatment groups in the proportion of subjects who show < -0.50 D myopia progression (SER) at 24 months.

Source: https://euclinicaltrials.eu/ctis-public/view/2023-510439-13-00